EU clinical trial 2022-502467-38-00: ETOP 21-21 BOUNCE: A multicentre, randomised, phase II trial of brigatinib consolidation versus observation or durvalumab in patients with unresectable stage III NSCLC and ALK-rearrangement, after definitive chemo-radiotherapy.
Protocol code: ETOP 21-21 BOUNCE
Sponsor: ETOP IBCSG Partners Foundation (Laboratory/Research/Testing facility). Phase: Therapeutic exploratory (Phase II). Countries: Spain (ended), Italy (ended), France (ended), Poland (ended).
Therapeutic area(s): Diseases [C] - Respiratory Tract Diseases [C08]; Diseases [C] - Neoplasms [C04]
Gender: Female, Male. Age: 18-64 years, 65+ years. Enrolment: 41.
Status: Ended. Start date (EU): 2024-02-22. End date (EU): 2024-09-30. Decision date: 2023-11-10. Results received: Yes. Last updated: 2024-08-05.
Decision dates by country: FR: 2023-11-10, IT: 2023-11-10, PL: 2024-04-12, ES: 2023-11-13

Condition(s): Non-small cell lung cancer (NSCLC)
Product: BRIGATINIB, BRIGATINIB, IMFINZI 50 mg/mL concentrate for solution for infusion., IMFINZI 50 mg/mL concentrate for solution for infusion.

Primary endpoint: Progression-free survival, according to RECIST v1.1, evaluated in the ITT cohort. PFS will be compared between the two arms.
Endpoint(s): Overall survival, CNS-relapse-free survival, Patterns of disease progression, Toxicity according to CTCAE v5.0

Source: https://euclinicaltrials.eu/ctis-public/view/2022-502467-38-00